EU clinical trial 2024-512383-65-00: A Phase II Multicenter, Open-Label Study to evaluate the Efficacy, Safety, Pharmacokinetics, and Pharmacodynamics of Satralizumab in Pediatric Patients with Duchenne Muscular Dystrophy (SHIELD DMD)
Protocol code: BN45398
Sponsor: F. Hoffmann-La Roche AG (Pharmaceutical company). Phase: Therapeutic exploratory (Phase II). Countries: Poland (ongoing, recruitment ended), Spain (ongoing, recruitment ended), Italy (ongoing, recruitment ended), Denmark (ongoing, recruitment ended).
Therapeutic area(s): Diseases [C] - Musculoskeletal Diseases [C05]; Diseases [C] - Congenital, Hereditary, and Neonatal Diseases and Abnormalities [C16]; Diseases [C] - Nervous System Diseases [C10]
Gender: Male. Age: 0-17 years. Enrolment: 28.
Status: Ongoing, recruitment ended. Start date (EU): 2024-09-26. Decision date: 2024-09-09. Results received: No. Last updated: 2025-10-31.
Decision dates by country: PL: 2024-09-16, ES: 2024-09-09, IT: 2024-09-10, DK: 2025-09-22

Condition(s): Duchenne Muscular Dystrophy (DMD)

Primary endpoint: 1. Change from baseline to Week 52 in LS BMD Z-score measured by DEXA
Endpoint(s): 1. Incidence of treatment-emergent adverse events, 2. Incidence of serious adverse events, 3. Incidence of adverse events of special interest, 4. Clinically significant changes in vital signs and physical examination findings, 5. Clinically significant changes in safety laboratory assessments, ECGs, 6. Change from baseline to Weeks 24, 52 and 104 in LS BMD Z-score measured by DEXA, 7. Change from baseline to Weeks 24, and 52 and 104 in TBLH BMD Z-score measured by DEXA, 8. Change from baseline to Week 24, week 52 and week 104 in total hip BMD Z-score measured by DEXA, 9 . Change from baseline to Weeks 12, 24 and 52 in circulating bone metabolism biomarkers, 10 . Number of new low-trauma long-bone or vertebral fractures by Week 52 and week 104, 11 . Proportion of Participants with new low-trauma long-bone or vertebral fracture by Week 52 and week 104, 12. Summary of observed serum concentration of satralizumab at specified trough timepoints up to Week 104, 13. Population and individual estimates of PK parameters (e.g., apparent clearance and apparent volume of distribution) and secondary PK parameters (e.g., area under the concentration-time curve), 14. Prevalence of ADAs at baseline and incidence of ADAs during the study

Source: https://euclinicaltrials.eu/ctis-public/view/2024-512383-65-00